EU clinical trial 2023-506369-79-00: Brightline-2: A Phase IIa/IIb, open-label, single-arm, multi-centre trial of BI 907828 for treatment of patients with locally advanced / metastatic, MDM2 amplified, TP53 wild-type biliary tract adenocarcinoma, pancreatic ductal adenocarcinoma, or other selected solid tumours
Protocol code: 1403-0011
Sponsor: Boehringer Ingelheim International GmbH, Boehringer Ingelheim Espana S.A., Boehringer Ingelheim RCV GmbH & Co. KG (Pharmaceutical company). Phase: Therapeutic exploratory (Phase II). Countries: Spain (ended), France (ended), Belgium (ended), Germany (ended), Austria (ended).
Therapeutic area(s): Diseases [C] - Neoplasms [C04]
Gender: Female, Male. Age: 18-64 years, 65+ years. Enrolment: 38.
Status: Ended. Start date (EU): 2022-11-30. End date (EU): 2025-06-25. End date: 2025-09-25. Decision date: 2023-10-30. Results received: No. Last updated: 2025-06-02.
Decision dates by country: AT: 2023-11-09, FR: 2023-11-07, DE: 2023-11-02, BE: 2023-10-31, ES: 2023-10-30

Condition(s): Pancreatic ductal adenocarcinoma, Lung adenocarcinoma, Biliary tract adenocarcinoma, Urothelial bladder cancer
Product: BI 907828, BI 907828, BI 907828

Primary endpoint: Objective response (OR) based on central independent review
Endpoint(s): Duration of objective response (DOR) based on central independent review, Progression-free survival (PFS) based on central independent review, Overall survival (OS), Disease control (DC) based on central independent review, Occurrence of treatment-emergent adverse events (AEs) during the on-treatment period., Occurrence of treatment-emergent AEs leading to trial drug discontinuation during the on-treatment period., Change from baseline in EORTC QLQ-C30 physical functioning domain score, Change from baseline in EORTC QLQ-C30 fatigue domain score, Change from baseline in EORTC QLQ-C30 role functioning domain score, Change from baseline in EORTC QLQ-BIL21 tiredness domain score

Source: https://euclinicaltrials.eu/ctis-public/view/2023-506369-79-00